EU clinical trial 2023-509140-10-00: A Phase 3, Randomized, Double-Blind, Placebo_Controlled Study to Evaluate Sotatercept When Added to Maximum Tolerated Background Therapy in Participants With Pulmonary Arterial Hypertension (PAH) World Health Organization (WHO) Functional Class (FC) III or FC IV at High Risk of Mortality
Protocol code: A011-14
Sponsor: Acceleron Pharma Inc. (Pharmaceutical company). Phase: Therapeutic confirmatory (Phase III). Countries: Belgium (ended), Netherlands (ended), Germany (ended), Italy (ended), France (ended), Spain (ended).
Therapeutic area(s): Diseases [C] - Cardiovascular Diseases [C14]
Gender: Female, Male. Age: 18-64 years, 65+ years. Enrolment: 85.
Status: Ended. Start date (EU): 2022-04-05. End date (EU): 2025-02-18. End date: 2025-02-19. Decision date: 2024-08-27. Results received: Yes. Last updated: 2024-09-17.
Decision dates by country: NL: 2024-08-27, FR: 2024-09-04, DE: 2024-08-29, IT: 2024-09-17, ES: 2024-09-06, BE: 2024-08-28

Condition(s): Pulmonary Arterial Hypertension (PAH)
Product: PL1 - Lyophilisate and solvent for solution for injection, sotatercept

Primary endpoint: The primary efficacy endpoint is the time to first event of all-cause death, lung transplantation, or PAH worsening-related hospitalization of ≥ 24 hours.
Endpoint(s): Overall survival Transplant-free survival Proportion of participants with mortality event at EOS Change from BL in REVEAL Lite 2.0 risk score -Wk 24 Proportion of participants achieved REVEAL Lite 2.0 risk score ≤ 7-Wk 24 Change from BL in NT-proBNP levels -Wk 24 Change from BL in mPAP -Wk 24 Change from BL in PVR -Wk 24, Proportion of participants improved in WHO FC at end of DBPC Tx Period Change from BL in 6MWD -Wk 24 Change from BL in CO -Wk 24 Change from BL in EQ-5D-5L index score -Wk 24

Source: https://euclinicaltrials.eu/ctis-public/view/2023-509140-10-00